EU clinical trial 2023-510449-51-00: KISS Evaluation of early administration of Levetiracetam in the prevention and treatment of delirium during septic shock: a randomized, double-blind, placebo-controlled trial.
Protocol code: APHP200068
Sponsor: Assistance Publique Hopitaux De Paris (Hospital/Clinic/Other health care facility). Phase: Therapeutic confirmatory (Phase III). Countries: France (ongoing, recruiting).
Therapeutic area(s): Diseases [C] - Bacterial Infections and Mycoses [C01]
Gender: Female, Male. Age: 18-64 years, 65+ years. Enrolment: 280.
Status: Ongoing, recruiting. Start date (EU): 2025-07-31. Decision date: 2024-11-08. Results received: No. Last updated: 2025-05-12.

Condition(s): Adult ICU patients with septic shock
Product: SODIUM CHLORIDE, LEVETIRACETAM VIATRIS 100 mg/ml, solution à diluer pour perfusion

Primary endpoint: The primary endpoint of the KiSS study will be the number of days alive without delirium or coma at D14 following randomization.
Endpoint(s): Mortality in intensive care, in hospital, at D28 and D90, Overall survival at D90, The number of days without mechanical ventilation at D28: the duration between the start and end of mechanical ventilation including invasive, non-invasive mechanical ventilation and high-flow oxygen therapy of the Optiflow™ type (Fisher &. Paykel, Courtabœuf, France). The use of non-invasive ventilation or CPAP for the treatment of sleep apnea or chronic obstructive or restrictive respiratory insufficiency are not taken into account. Translated with DeepL.com (free version), Number of days alive outside the intensive care unit at D28 and outside the hospital at D90, Cumulative incidence and type of epileptic seizures between D1 and D14, The time between cessation of sedation and awakening, Severity of cognitive impairment at D90, Severity of anxiety and depression at D90, Presence of post-traumatic stress at J90, Health-related quality of life at D90, Autonomy in daily life at D90

Source: https://euclinicaltrials.eu/ctis-public/view/2023-510449-51-00